EU clinical trial 2023-509133-39-00: EPIK-B5: A Phase III, randomized, double-blind, placebo-controlled study of alpelisib (BYL719) in combination with fulvestrant for men and postmenopausal women with HR-positive, HER2-negative advanced breast cancer with a PIK3CA mutation, who progressed on or after aromatase inhibitor and a CDK4/6 inhibitor
Protocol code: CBYL719C2303
Sponsor: Novartis Pharma AG (Pharmaceutical company). Phase: Therapeutic confirmatory (Phase III). Countries: Slovakia (ongoing, recruitment ended), Ireland (ongoing, recruitment ended), Bulgaria (ongoing, recruitment ended), Romania (ended), Poland (ended), Greece (ended), Portugal (ongoing, recruitment ended), Finland (ongoing, recruitment ended), Spain (ongoing, recruitment ended), Italy (ongoing, recruitment ended), Germany (ongoing, recruitment ended), Czechia (ongoing, recruitment ended), Denmark (ended), Hungary (ongoing, recruitment ended), Belgium (ongoing, recruitment ended), France (ongoing, recruitment ended).
Therapeutic area(s): Diseases [C] - Neoplasms [C04]
Gender: Female, Male. Age: 18-64 years, 65+ years. Enrolment: 240.
Start date (EU): 2021-11-29. Decision date: 2024-07-10. Results received: No. Last updated: 2026-05-04.
Decision dates by country: RO: 2024-07-15, DK: 2025-04-22, DE: 2024-07-31, GR: 2024-09-25, HU: 2024-07-15, IE: 2024-07-10, PL: 2024-08-04, CZ: 2024-07-12, SK: 2024-07-12, ES: 2024-07-18, IT: 2024-07-29, FI: 2024-07-11, BE: 2024-07-16, PT: 2024-07-12, FR: 2024-07-29, BG: 2024-08-16

Condition(s): Hormone receptor positive, HER2-negative advanced breast cancer
Product: ALPELISIB, FULVESTRANT, ALPELISIB, Placebo to BYL719 50 mg film-coated tablet Light pink Placebo to BYL719 200 mg film-coated tablet Light red

Primary endpoint: Progression-free survival (PFS) based on BIRC assessments and using RECIST v1.1 criteria
Endpoint(s): Overall survival, Overall response rate (ORR) with confirmed response, clinical benefit rate (CBR) with confirmed response, duration of response (DOR) with confirmed response, and time to response (TTR) based on BIRC assessment and RECIST v1.1, PFS based on BIRC assessment and using RECIST v1.1 criteria for participants by PIK3CA mutation status assessed in ctDNA at baseline, Incidence, type and severity of adverse events per CTCAE v4.03 criteria, Time to definitive deterioration of ECOG performance status from baseline, Time to definitive (10%) deterioration in the global health status/Quality of Life (QoL) and symptom scale scores of the EORTC QLQ-C30 Change from baseline in global health status/QoL and symptom scale scores of the EORTC QLQ-C30, Time from randomization to objective tumour progression on next line treatment or death from any cause (PFS2)

Source: https://euclinicaltrials.eu/ctis-public/view/2023-509133-39-00